EU clinical trial 2023-504451-27-01: Treating socket discharge and discomfort: randomized test of vitamin A ointment, low-dose steroids and artificial tears
Sponsor: Amsterdam UMC (Hospital/Clinic/Other health care facility). Phase: Therapeutic use (Phase IV). Countries: Netherlands (ended).
Therapeutic area(s): Diseases [C] - Eye Diseases [C11]
Gender: Female, Male. Age: 18-64 years, 65+ years. Enrolment: 40.
Status: Ended. Start date (EU): 2024-02-29. End date (EU): 2024-09-14. Decision date: 2023-09-09. Results received: Yes. Last updated: 2023-10-18.

Condition(s): Chronic mucopurulent discharge and/or discomfort of the ocular prosthesis socket
Product: RETINOL PALMITATE, Hylan 0,15/0,15 mg/ml, oogdruppels, oplossing, FML Liquifilm 0,1%, oogdruppels, suspensie

Primary endpoint: Change of discomfort score and discharge score and discharge score from baseline till 2-week use of either: Artificial eyedrops, topical vitamin A ointment or low-dose topical steroids
Endpoint(s): We also attempt to characterize the patients who will benefit from either artificial eyedrops, topical vitamin A ointemnt of low-dose steroids

Source: https://euclinicaltrials.eu/ctis-public/view/2023-504451-27-01